EU clinical trial 2022-500745-24-00: A randomized phase II trial on the addition of dutasteride to combined androgen blockade therapy versus combined androgen blockade therapy alone in patients with recurrent and/or metastatic salivary duct carcinoma – DUCT study
Sponsor: Stichting Radboud University Medical Center (Hospital/Clinic/Other health care facility). Phase: Phase II and Phase III (Integrated). Countries: Netherlands (ongoing, recruiting).
Therapeutic area(s): Diseases [C] - Neoplasms [C04]
Gender: Female, Male. Age: 18-64 years, 65+ years. Enrolment: 26.
Status: Ongoing, recruiting. Start date (EU): 2022-09-20. Decision date: 2022-08-11. Results received: No. Last updated: 2024-04-18.

Condition(s): Salivary Duct Carcinoma
Product: Zoladex-10,8, implantatiestaafje 10,8 mg, Casodex-50, filmomhulde tabletten 50 mg, Avodart 0,5 mg zachte capsules

Primary endpoint: Overall response rate (ORR) defined as proportion of participants who have a confirmed complete response (CR) or partial response (PR) determined by Investigator according to RECIST v1.1, Duration of Response (DoR), defined as the time from first tumor assessment at which the overall response was recorded as PR or CR that is subsequently confirmed until documented progressive disease (PD) determined by Investigator per RECIST v1.1 or death from any cause, whichever occurs first
Endpoint(s): Progression free survival (PFS), defined as the time from study enrolment until the date of first documented disease progression by Investigator as per RECIST v1.1, or death due to any cause, whichever occurs first, Overall survival (OS), defined as the time from study enrolment to the date of death due to any cause, Clinical benefit rate (CBR) including confirmed CR or PR at any time or stable disease (SD) of at least 6 months determined by Investigator as per RECIST v1.1, Incidence of SAE’s according to National Cancer Institute Common Terminology Criteria for Adverse Events version 5.0., Quality of life (QoL) assessments according to approved EORTC (QLQ-C30, QLQ-H&N35, QLQ-SHQ22) and VAS questionnaires, Circulating tumor DNA (ctDNA) and serum testosterone, AR, AR splice variants and SRD5A1/SRD5A2 mRNA expression on baseline and post-treatment tumor tissue samples, Various subsets of immune cells. Including different panels, but not limited to, a lymphocyte panel, a dendritic cell panel, a checkpoint panel, and a myeloid-derived suppressor cell panel

Source: https://euclinicaltrials.eu/ctis-public/view/2022-500745-24-00